EU clinical trial 2024-514955-13-00: COMparison of B-cell dePletion by rituximAb and anti-CD 19 CAR-T therapy in patients with rhEumatoid arthritis- The COMPARE TRIAL TWO - STAGE INTERVENTIONAL, PROSPECTIVE, RANDOMIZED, CONTROLLED, OPEN LABEL, PARALLEL - GROUP PHASE I/II TRIAL IN PATIENTS WITH ACTIVE, ACPA – POSITIVE AND TREATMENT REFRACTORY RHEUMATOID ARTHRITIS
Protocol code: CCM-RNT-202401
Sponsor: Charite Universitaetsmedizin Berlin KöR (Hospital/Clinic/Other health care facility). Phase: Phase I and Phase II (Integrated)- Other. Countries: Germany (ongoing, recruiting).
Therapeutic area(s): Diseases [C] - Immune System Diseases [C20]; Diseases [C] - Musculoskeletal Diseases [C05]
Gender: Female, Male. Age: 18-64 years, 65+ years. Enrolment: 16.
Status: Ongoing, recruiting. Start date (EU): 2024-11-29. Decision date: 2024-11-01. Results received: No. Last updated: 2026-01-28.
Decision dates by country: DE: 2024-12-06

Condition(s): Rheumatoid Arthritis
Product: Rixathon 500 mg concentrate for solution for infusion, KYV-101

Primary endpoint: Safety (Phase I): Incidence and grading of severity (graded 0-4) of Cytokine Release Syndrome (CRS) and of Immune cCell Associated Neurotoxicity Syndrome (ICANS) as well as AE and SAE due to IMP within the first 4 weeks after anti-CD19 CAR T cell therapy. Participants of Phase I will continue to be observed over a total period of 52 weeks for AE and SAE, ACPA seroconversion and efficacy endpoints., Safety (Phase II): AE and SAE due to IMP and rituximab throughout the whole study., Efficacy (Phase II): Percentage of subjects with ACPA seroconversion = ACPA level <20 mU/ml at week 16.
Endpoint(s): Clinical secondary endpoint (Phase II): Drug free survival time (beginning of immunosuppression for RA treatment except for stable dosage of MTX in the control arm) from week 7 to 52, Clinical secondary endpoint (Phase II): Time to relapse/flare from week 7 to week 52, Clinical secondary endpoint (Phase II): ACR 20/50/70 response at week 16, 24 and 52 weeks, Clinical secondary endpoint (Phase II): DAS28-CRP remission at 16, 24, and 52 weeks, Clinical secondary endpoint (Phase II): DAS28-CRP<3.2 at week 16, 24 and 52, Clinical secondary endpoint (Phase II): SDAI remission at 16, 24, and 52 weeks, Clinical secondary endpoint (Phase II): Boolean 2.0 remission at 16, 24, and 52 weeks, Clinical secondary endpoint (Phase II): Change in DAS28-CRP at 16, 24, and 52 weeks, Clinical secondary endpoint (Phase II): Change in ACR score components at 16, 24, and 52 weeks, Clinical secondary endpoint (Phase II): Change in SDAI and CDAI at 16, 24, and 52 weeks, Clinical secondary endpoint (Phase II): Number of flares until 16, 24 and 52 weeks, Cellular and humoral response (Phase II): Percentage of subjects with ACPA seroconversion = ACPA level <20 mU/ml at week 24 and 52, Cellular and humoral response (Phase II): Duration of persistence of CAR T cells in the peripheral blood, Cellular and humoral response (Phase II): Duration of B cell depletion in the peripheral blood, Cellular and humoral response (Phase II): Expansion of CAR T cells in the patient over time, Cellular and humoral response (Phase II): Change in ACPA levels (mU/ml) over time, Cellular and humoral response (Phase II): Change in RF levels (U/ml) over time, Cellular and humoral response (Phase II): Change in ACPA levels (mU/ml) in HLA-defined subgroups over time, Cellular and humoral response (Phase II): Change in levels of ACPA isotypes and IgG subclasses at week over time, Cellular and humoral response (Phase II): Change in total IgG, IgG subclasses and IgA, IgM immunoglobulins over time, Cellular and humoral response (Phase II): Change in the number of plasmablasts, B cell and T cell numbers over time in peripheral blood, additional endpoint (Phase II): Patient’s Global Assessment (PtGA) of disease activity (VAS 0-100mm), additional endpoint (Phase II): Physician’s Global Assessment (PhGA) of disease activity (VAS 0-100mm), additional endpoint (Phase II): Health Assessment Questionnaire – Disease Index (HAQ-DI), additional endpoint (Phase II): Functional Assessment of Chronic Illness Therapy - Fatigue (FACIT), additional endpoint (Phase II): Short Form 36 (SF-36, quality of life questionnaire), additional endpoint (Phase II): Questionnaire on work productivity and activity impairment (WPAI), additional endpoint (Phase II): Change in hand strength over time, additional endpoint (Phase II): Change in radiological Sharp-van-der-Heijde score (hands and feet), additional endpoint (Phase II): Change in MRI RAMRIS score, additional endpoint (Phase II): Change of EULAR-OMERACT US synovitis scoring system, Exploratory endpoint (Phase II): Change in ACPA specific plasmablasts and B cells, Exploratory endpoint (Phase II): To analyze the changes in B cell receptor repertoire, Exploratory endpoint (Phase II): To evaluate the therapy-induced changes of B cell subsets, Exploratory endpoint (Phase II): Characterizing B Cell and Plasma Cell Niches in Tissues, Exploratory endpoint (Phase II): To evaluate the influence of therapy on auto-antigen-specific B cells, Exploratory endpoint (Phase II): To evaluate the therapy-induced alterations of T cell compartments, Exploratory endpoint (Phase II): To evaluate the impact of therapy on Immunoglobulin glycosylation, Exploratory endpoint (Phase II): To evaluate changes in lymphocyte numbers and composition in bone marrow biopsy, synovial biopsy, lymph node biopsy and synovial fluid, Exploratory endpoint (Phase II): To repeat all statistical assessments using pooled data from CAR T patients in phase I and II

Source: https://euclinicaltrials.eu/ctis-public/view/2024-514955-13-00